EU clinical trial 2024-514698-23-00: A Double-blind, Placebo-Controlled, Multicenter Study With an Open-label Extension to Evaluate the Efficacy and Safety of SRP-4045 and SRP-4053 in Patients With Duchenne Muscular Dystrophy
Protocol code: 4045-301
Sponsor: Sarepta Therapeutics Inc. (Pharmaceutical company). Phase: Therapeutic confirmatory (Phase III). Countries: Belgium (ended), Ireland (ended), Poland (ended), Bulgaria (ended), Denmark (ended), Italy (ended), Spain (ended), Czechia (ended), Hungary (ended).
Therapeutic area(s): Diseases [C] - Musculoskeletal Diseases [C05]
Gender: Male. Age: 0-17 years. Enrolment: 81.
Status: Ended. Start date (EU): 2017-05-15. End date (EU): 2025-10-09. End date: 2025-10-17. Decision date: 2024-07-22. Results received: No. Last updated: 2025-06-19.
Decision dates by country: IE: 2024-07-29, BE: 2024-07-26, BG: 2024-07-29, CZ: 2024-07-25, DK: 2024-07-24, HU: 2024-07-22, IT: 2024-08-12, ES: 2024-07-22, PL: 2024-08-04

Condition(s): Patients with Duchenne Muscular Dystrophy Amenable to Exon 45 or 53 Skipping.
Product: CASIMERSEN (SRP-4045), GOLODIRSEN (SRP-4053), 0,9% sodium chloride

Primary endpoint: Double-blind period: Change from Baseline at Week 96 in 4-step ascend velocity (step/second)
Endpoint(s): • Change from Baseline at Week 96 in 6MWT • Change from Baseline at Week 96 in rise from floor velocity (rise/second) • Change from Baseline at Week 144 in 4-step ascend velocity (step/second), • Change from Baseline at Week 96 in 10MWR velocity (meter/second) • Change from Baseline at Weeks 48 or 96 in the quantity of dystrophin protein expression as measured by Western blot of biopsied muscle tissue., • Change from Baseline at Weeks 48 or 96 in the intensity of dystrophin expression in biopsied muscle tissue, as measured by IHC. •Change from Baseline at Week 96 in: NSAA total score

Source: https://euclinicaltrials.eu/ctis-public/view/2024-514698-23-00